EU clinical trial 2024-512901-22-00: Utility of intra-abdominal pressure and clinical ultrasound for guiding diuretic treatment in patients with acute heart failure
Protocol code: PI23/00797
Sponsor: Fundacion Instituto De Investigacion Sanitaria Aragon (Laboratory/Research/Testing facility). Phase: Therapeutic confirmatory (Phase III). Countries: Spain (ongoing, recruiting).
Therapeutic area(s): Diseases [C] - Cardiovascular Diseases [C14]
Gender: Female, Male. Age: 18-64 years, 65+ years. Enrolment: 168.
Status: Ongoing, recruiting. Start date (EU): 2025-02-10. Decision date: 2024-08-01. Results received: No. Last updated: 2026-05-25.

Condition(s): Acute Heart Failure
Product: FUROSEMIDE, FUROSEMIDE, HYDROCHLOROTHIAZIDE, FUROSEMIDE

Primary endpoint: Congestion absence after the first 72h of intravenous diuretic treatment in hospitalization as determined by the ADVOR scale.

Source: https://euclinicaltrials.eu/ctis-public/view/2024-512901-22-00